EU clinical trial 2024-514840-97-00: A MultIceNTER Phase I Peptide VaCcine Trial to Exploit NeoePitope-Specific T Cells for the Treatment of H3-Mutated Gliomas – (INTERCEPT H3)
Sponsor: Deutsches Krebsforschungszentrum Stiftung Des Oeffentlichen Rechts (Laboratory/Research/Testing facility). Phase: Human Pharmacology (Phase I)- Other. Countries: Germany (ongoing, recruitment ended).
Therapeutic area(s): Diseases [C] - Neoplasms [C04]
Gender: Female, Male. Age: 18-64 years, 65+ years. Enrolment: 15.
Status: Ongoing, recruitment ended. Start date (EU): 2023-02-15. Decision date: 2024-08-08. Results received: No. Last updated: 2025-12-03.

Condition(s): glioma WHO grade IV (C71.1-9 according to ICD-10 classification)

Source: https://euclinicaltrials.eu/ctis-public/view/2024-514840-97-00